EU clinical trial 2022-500713-79-00: Anti-PD-1 re-challenge after immune priming by ipilimumab and immune boosting by radiotherapy in advanced NSCLC.
Sponsor: Stichting Het Nederlands Kanker Instituut-Antoni Van Leeuwenhoek Ziekenhuis (Hospital/Clinic/Other health care facility). Phase: Phase II and Phase III (Integrated). Countries: Netherlands (ongoing, recruitment ended).
Therapeutic area(s): Diseases [C] - Neoplasms [C04]
Gender: Female, Male. Age: 18-64 years. Enrolment: 54.
Status: Ongoing, recruitment ended. Start date (EU): 2023-01-03. Decision date: 2022-10-13. Results received: No. Last updated: 2022-10-13.

Condition(s): Patients with advanced NSCLC who have progressed after at least previous anti-PD-(L)1 treatment and are ECOG 0-1 are allowed to participate irrespective of the level of tumor PD-L1 expression. Patients with advanced NSCLC with a targetable driver mutation may be found eligible, but only when all options for targeted therapy have been exhausted and when progression on previous PD-(L)1 blockade has occurred.
Product: LIBTAYO 350 mg concentrate for solution for infusion., YERVOY 5 mg/ml concentrate for solution for infusion

Primary endpoint: The primary endpoint will be CBR defined as CR or PR at any time point and SD lasting ≥6 months after re-introduction of PD-1 inhibition by cemiplimab (Day 1 of Week 27) as defined by RECIST 1.1. The primary endpoint includes patients having a CR or PR but who show PD prior to the 6 month’ time point from start of treatment. Lesions that were irradiated as part of study treatment are not eligible as measurable disease by RECIST. Lesions that were irradiated prior to the study, but have progresse
Endpoint(s): Secondary endpoints of this trial will be ORR defined as CR or PR at 12 weeks after re-introduction of PD-1 inhibition by cemiplimab (Day 1 of Week 15) and DCR defined as CR, PR or SD at 12 weeks after re-introduction of PD-1 inhibition by cemiplimab (Day 1 of Week 15). Also, best overall response at any time point, PFS defined as time between start of treatment and PD or death and OS defined as time between start of treatment and death will be secondary endpoint. Safety of the study procedures

Source: https://euclinicaltrials.eu/ctis-public/view/2022-500713-79-00